EU clinical trial 2023-506361-56-00: A Phase 3 Randomized, Open-label, Active-comparator Controlled Clinical Study of Pembrolizumab versus Platinum Doublet Chemotherapy in Participants With Mismatch Repair Deficient (dMMR) Advanced or Recurrent Endometrial Carcinoma in the First-line Setting (KEYNOTE-C93/GOG-3064/ENGOT-en15)
Protocol code: MK-3475-C93
Sponsor: Merck Sharp & Dohme LLC (Pharmaceutical company). Phase: Therapeutic confirmatory (Phase III). Countries: Italy (ongoing, recruitment ended), Spain (ongoing, recruitment ended), Denmark (ended), Finland (ongoing, recruitment ended), Germany (ongoing, recruitment ended), Ireland (ongoing, recruitment ended), Belgium (ongoing, recruitment ended), Norway (ended), Hungary (ongoing, recruitment ended), Netherlands (ongoing, recruitment ended), Sweden (ongoing, recruitment ended), Czechia (ongoing, recruitment ended), Poland (ongoing, recruitment ended).
Therapeutic area(s): Diseases [C] - Neoplasms [C04]
Gender: Female. Age: 18-64 years, 65+ years. Enrolment: 153.
Start date (EU): 2022-04-01. Decision date: 2023-12-13. Results received: No. Last updated: 2026-07-22.
Decision dates by country: NO: 2023-12-14, PL: 2024-02-23, NL: 2023-12-14, CZ: 2023-12-15, DK: 2023-12-18, BE: 2023-12-18, FI: 2023-12-14, SE: 2023-12-14, HU: 2023-12-14, ES: 2023-12-15, IE: 2023-12-13, IT: 2023-12-19, DE: 2023-12-18

Condition(s): Endometrial cancer
Product: KEYTRUDA 25 mg/mL concentrate for solution for infusion, PACLITAXEL, CISPLATIN, CARBOPLATIN, DOCETAXEL

Primary endpoint: Progression-Free Survival (PFS) per Response Evaluation Criteria in Solid Tumors Version 1.1 (RECIST 1.1) as Assessed by Blinded Independent Central Review (BICR), Overall survival (OS)
Endpoint(s): Objective Response Rate (ORR) per RECIST 1.1 as Assessed by BICR, Disease Control Rate (DCR) per RECIST 1.1 as Assessed by BICR, Duration of Response (DOR) per RECIST 1.1 as Assessed by BICR, PFS per RECIST 1.1 as Assessed by Investigator, Progression-Free Survival 2 (PFS2) per RECIST 1.1 as Assessed by Investigator, Number of Participants Who Experience at Least One Adverse Event (AE), Number of Participants Who Discontinue Study Treatment Due to an AE, Change From Baseline in European Organization for Research And Treatment of Cancer Quality of Life Questionnaire-Core 30 (EORTC QLQ-C30) Global Health Status (GHS) (Item 29) And Quality of Life (QoL) (Item 30) Combined Score

Source: https://euclinicaltrials.eu/ctis-public/view/2023-506361-56-00